EU clinical trial 2023-506899-27-00: A Phase III, Open-Label, Multicenter, Randomized Study Evaluating the Efficacy and Safety of Glofitamab in Combination with Gemcitabine Plus Oxaliplatin Versus Rituximab in Combination with Gemcitabine and Oxaliplatin in Patients with Relapsed/Refractory Diffuse Large B-Cell Lymphoma
Protocol code: GO41944
Sponsor: F. Hoffmann-La Roche AG (Pharmaceutical company). Phase: Therapeutic confirmatory (Phase III). Countries: Denmark (ongoing, recruitment ended), Poland (ongoing, recruitment ended), France (ongoing, recruitment ended), Germany (ongoing, recruitment ended), Spain (ongoing, recruitment ended), Belgium (ongoing, recruitment ended).
Therapeutic area(s): Diseases [C] - Neoplasms [C04]
Gender: Female, Male. Age: 18-64 years, 65+ years. Enrolment: 85.
Status: Ongoing, recruitment ended. Start date (EU): 2021-03-25. Decision date: 2024-05-17. Results received: No. Last updated: 2026-06-08.
Decision dates by country: DK: 2024-05-17, FR: 2024-05-24, ES: 2024-05-17, DE: 2024-05-22, PL: 2024-05-24, BE: 2024-06-21

Condition(s): Relapsed or refractory diffuse large B-cell lymphoma
Product: Glofitamab, Gazyvaro 1,000 mg concentrate for solution for infusion., MabThera 500 mg concentrate for solution for infusion, RoActemra 20 mg/mL concentrate for solution for infusion

Primary endpoint: 1. Overall Survival
Endpoint(s): 1. Progression-Free Survival by Independent review committee (IRC) and Investigator, 2. Complete response rate by IRC and Investigator, 3. Objective response rate by IRC and Investigator, 4. Duration of objective response, 5. Duration of complete response, 6. Time to deterioration in physical functioning and fatigue, as measured by the European Organisation for Research and Treatment of Cancer Quality of Life−Core 30 Questionnaire (EORTC QLQ-C30) and in lymphoma symptoms, as measured by the Functional Assessment of Cancer Therapy−Lymphoma subscale (FACT-Lym LymS), 7. Incidence and severity of adverse events, with severity determined according to NCI CTCAE v5.0, including cytokine-release syndrome (CRS), with severity determined according to the American Society for Transplantation and Cellular Therapy (ASTCT) CRS grading criteria, 8. Change from baseline in targeted vital signs, 9. Change from baseline in targeted clinical laboratory test results, 10. Tolerability, as assessed by dose interruptions, dose reductions, and dose intensity, and study treatment discontinuation because of adverse events, 11. Minimum serum concentration of glofitamab, 12. Maximum serum concentration of glofitamab, 13. Area under the concentration-time curve (AUC) for serum concentration−time profile of glofitamab estimated using a population-PK model, 14. Minimum serum concentration of obinutuzumab, 15. Maximum serum concentration of obinutuzumab, 16. Prevalence of anti-drug antibodies (ADAs) against glofitamab at baseline and incidence of ADAs during the study

Source: https://euclinicaltrials.eu/ctis-public/view/2023-506899-27-00